EU clinical trial 2024-515836-61-00: Combination of ALpelisib and Trametinib in progressive REfractory Meningiomas
Sponsor: Centre Hospitalier Regional De Marseille (Hospital/Clinic/Other health care facility). Phase: Human Pharmacology (Phase I)- First administration to humans. Countries: France (ongoing, recruiting).
Therapeutic area(s): Diseases [C] - Neoplasms [C04]; Diseases [C] - Nervous System Diseases [C10]
Gender: Female, Male. Age: 18-64 years, 65+ years. Enrolment: 35.
Status: Ongoing, recruiting. Start date (EU): 2019-09-30. Decision date: 2024-08-14. Results received: No. Last updated: 2026-02-19.

Condition(s): Menangiomas

Source: https://euclinicaltrials.eu/ctis-public/view/2024-515836-61-00